EU clinical trial 2023-504258-36-00: Bioequivalence of Ulipristal Acetate 30 mg Tablets: A Single-Dose, Open-Label, Randomized, Two-Sequence, Two Treatment, Two-Period Crossover Study in Healthy Subjects Under Fasting Conditions.
Protocol code: BLCL-ULI-FDA-01
Sponsor: Laboratorios Leon Farma S.A. (Pharmaceutical company). Phase: Human Pharmacology (Phase I)- Bioequivalence Study. Countries: Portugal (ended).
Therapeutic area(s): Not possible to specify
Gender: Female. Age: 18-64 years. Enrolment: 60.
Status: Ended. Start date (EU): 2023-09-01. End date (EU): 2023-10-25. Decision date: 2023-05-29. Results received: Yes. Last updated: 2023-05-29.

Condition(s): No medical condition
Product: ULIPRISTAL ACETATE, Ulipristal 30 mg tablet

Primary endpoint: Cmax and AUC0-72 of ulipristal acetate will be the primary pharmacokinetic parameters for the bioequivalence assessment.
Endpoint(s): Safety will be evaluated through the assessment of adverse events (AEs), ECG, vital signs, and clinical laboratory tests.

Source: https://euclinicaltrials.eu/ctis-public/view/2023-504258-36-00